EU clinical trial 2024-515162-13-00: BRISOTE: A Multicentre, Randomised, Double-blind, Parallel Group, Active-Controlled, Phase 3b Study to Evaluate the Efficacy and Safety of Benralizumab 30 mg SC in Eosinophilic Asthma Patients Uncontrolled on Medium-Dose Inhaled Corticosteroid Plus Long-acting β2 Agonist
Protocol code: D3250C00101
Sponsor: AstraZeneca AB (Pharmaceutical company). Phase: Therapeutic confirmatory (Phase III). Countries: Italy (ongoing, recruitment ended), France (ongoing, recruitment ended), Ireland (ongoing, recruitment ended), Spain (ongoing, recruitment ended), Norway (ongoing, recruitment ended), Germany (ongoing, recruitment ended), Bulgaria (ongoing, recruitment ended).
Therapeutic area(s): Diseases [C] - Respiratory Tract Diseases [C08]
Gender: Female, Male. Age: 18-64 years, 65+ years. Enrolment: 172.
Status: Ongoing, recruitment ended. Start date (EU): 2025-04-29. Decision date: 2025-03-17. Results received: No. Last updated: 2026-04-29.
Decision dates by country: IE: 2025-03-21, IT: 2025-03-18, NO: 2025-04-02, FR: 2025-03-18, DE: 2025-03-19, BG: 2025-03-17, ES: 2025-03-18

Condition(s): Eosinophilic Asthma
Product: Placebo for Benralizumab, Fasenra 30 mg solution for injection in pre-filled syringe, Symbicort forte Turbuhaler 320 microgramos/9 microgramos/inhalación polvo para inhalación., Symbicort Turbuhaler 160 microgramos/4,5 microgramos/inhalación polvo para inhalación

Primary endpoint: Endpoint: AAER during the 48-week treatment period.
Endpoint(s): Change from baseline in SGRQ total score to EOT (Week 48)

Source: https://euclinicaltrials.eu/ctis-public/view/2024-515162-13-00